EU clinical trial 2024-515955-39-01: TOPical sirolimus in linGUal microkystic lymphatic malformation
Protocol code: TOPGUN
Sponsor: Centre Hospitalier Regional Universitaire De Tours (Hospital/Clinic/Other health care facility). Phase: Therapeutic exploratory (Phase II). Countries: France (ended).
Therapeutic area(s): Diseases [C] - Hemic and Lymphatic Diseases [C15]
Gender: Female, Male. Age: 0-17 years, 18-64 years. Enrolment: 12.
Status: Ended. Start date (EU): 2020-02-04. End date (EU): 2025-01-08. Decision date: 2024-08-22. Results received: Yes. Last updated: 2024-08-22.

Condition(s): Lingual microcystic lymphatic malformations (LMLMs) are rare congenital vascular malformations, presenting as clusters of cysts filled with lymph fluid or blood. They are responsible for a heavy burden even with small well-limited lesions because of oozing, bleeding, infections, or even speech, chewing or breathing impairment. Pain and aesthetic prejudice are also frequently reported
Product: Rapamune 1 mg/mL oral solution

Primary endpoint: The primary outcome will consist in the evaluation of global severity of the LMLM using PGA (Physical Global Assessment) 0 to 5 score, by three independent blinded experts, on monthly standardized photographs. A 1-point improvement versus baseline in PGA scale would already have a clinical relevance. Our primary analysis will focus on change in PGA after topical application of Sirolimus for 12 weeks
Endpoint(s): Investigator-assessed PGA at weeks 0, 4, 8, 12, 16, 20 and 24, Assessment by the patient regarding severity of oozing, bleeding, sialorrhea, eating impairment, taste modification, aesthetic impairment, pain and global discomfort, each using a numeric scale from 0 to 10 (0: clear, 10: very severe), at weeks 0, 4, 8, 12, 16, 20 and 24, Global evolution compared to baseline, assessed by the patient from -10 to 10 (-10 = severe worsening, 0 = no change, 10 = complete recovery), at weeks 4, 8, 12, 16, 20 and 24, Global Quality of life assessment (DLQI or children’s DLQI for minors aged 5 to 16), at baseline, time of switch to treatment and W24, Measurement of the lesion (length, width, thickness) by the investigator, at baseline, time of switch to treatment and W24, Time to obtain optimal results, Safety: Assessment of tolerance of topical sirolimus: record of local adverse events at each visit, before and after the patient has crossed over to the intervention, Safety : record of general adverse events at each visit, before and after the patient has crossed over to the intervention, physical examination, systolic and diastolic blood pressure measurement, Safety: Assessment of sirolimus blood passage by measuring residual sirolimus blood concentration: after 4 weeks of treatment, then 8 weeks, then every 8 weeks until W24, Safety: Evaluation of biological safety at weeks 8, 16 and 24 of exposure compared to baseline (we will perform biological measurements that are required for assessing safety of oral sirolimus: complete blood count, liver (ASAT, ALAT, GGT) and renal (serum creatinine) functions, lipids [cholesterol i.e. total cholesterol, HDL and LDL calculation according to Friedwald's formula and triglycerides] and glycaemia)

Source: https://euclinicaltrials.eu/ctis-public/view/2024-515955-39-01